EU clinical trial 2024-511857-23-00: Monalizumab and MEDI5752 in patients with MSI and/or dMMR metastatic cancer (MONAMI)
Sponsor: Assistance Publique Hopitaux De Paris (Hospital/Clinic/Other health care facility). Phase: Therapeutic exploratory (Phase II). Countries: France (ended).
Therapeutic area(s): Diseases [C] - Pathological Conditions, Signs and Symptoms [C23]
Gender: Female, Male. Age: 18-64 years, 65+ years. Enrolment: 43.
Status: Ended. End date (EU): 2025-11-13. Decision date: 2024-11-14. Results received: No. Last updated: 2025-10-14.

Condition(s): cancerology
Product: volrustomig, Monalizumab

Primary endpoint: Of the safety lead-in : - Incidence of dose-limiting toxicities, - Incidence and severity of adverse events graded according to the NCI CTCAE version 5.0, - Incidence and severity of adverse events of special interest graded according to the NCI CTCAE version 5.0 - Incidence of dose interruptions, dose modifications and discon, Of the phase II study: - Objective response rate per RECIST v.1.1 criteria at 24 weeks since the initiation of the treatment, defined by the number of patients with partial or complete response at 24 weeks
Endpoint(s): Safety : Safety assessments will consist of monitoring and recording adverse events (AEs), including serious AEs (SAEs), performing protocol specified safety laboratory assessments, measuring protocol-specified vital signs, and conducting other protocol-specified tests (e.g., electrocardiogram) that are deemed critical to the safety evaluation of the study. The severity of AEs will be graded by Investigators according to NCI-CTCAE v5.0., Tumor response and progression : Tumor response will be assessed using RECIST v.1.1 and iRECIST criteria, Progression-free survival (PFS) : Death event will be assessed until the initiation of the subsequent anti-cancer therapy., Overall survival (OS) OS is defined as the time between beginning of treatment and death from any cause. Survival data will be censored at the last follow-up.

Source: https://euclinicaltrials.eu/ctis-public/view/2024-511857-23-00